EU clinical trial 2024-519389-28-00: Acute Effects of Partial GABA(A)-Receptor Modulation by GT-002 on Psychophysiological Measures: The TOTEMS Phase II Clinical Trial Targeting Cognitive Impairment Associated with Schizophrenia
Sponsor: Region Hovedstadens Psykiatriske (Hospital/Clinic/Other health care facility). Phase: Therapeutic exploratory (Phase II). Countries: Denmark (ongoing, recruiting).
Therapeutic area(s): Psychiatry and Psychology [F] - Mental Disorders [F03]
Gender: Female, Male. Age: 18-64 years. Enrolment: 50.
Status: Ongoing, recruiting. Start date (EU): 2026-05-07. Decision date: 2025-02-14. Results received: No. Last updated: 2026-05-12.

Condition(s): Patients must meet diagnostic criteria for schizophrenia, persistent delusional disorder, acute and transient psychotic disorders, induced delusional disorders, schizoaffective disorders, other non-organic psychotic disorders or unspecified non-organic psychosis (ICD-10: F20.x; F22.x; F23.x; F24.x; F25.x; F28; F29)
Product: Oxazepam "Alternova", tabletter, GT-002, Placebo for oxazepam: a placebo tablet containing no active drug substance, encapsulated to resemble the appearance of the encapsulated oxazepam tablet., Placebo for GT-002: a placebo soft gelatine capsule that is identical to the 1 mg gt-002 soft gelatine capsule and contains no active drug substance.

Primary endpoint: Change in Pre-pulse Inhibition of the Startle Reflex (PPI) in schizophrenia spectrum patients following exposure to GT-002, placebo, or oxazepam. The primary analysis will assess the difference between 2 mg GT-002 and placebo.
Endpoint(s): Changes in the Mismatch Negativity (MMN) paradigm, Selective Attention (SA) paradigm, 40-Hz Auditory Steady-State Response (40-Hz ASSR) paradigm, and frequency bands at resting state in schizophrenia spectrum patients following exposure to GT-002, oxazepam, or placebo., Safety and tolerability in both antipsychotic-treated schizophrenia spectrum patients and healthy controls, as measured by reported adverse events (AEs) and visual analogue mood scales (VAMS)., Changes in the EEG paradigms due to the differential acute effects between GT-002, oxazepam, and placebo in healthy controls., Changes in cognition due to GT-002 compared to oxazepam and placebo in both schizophrenia spectrum patients and healthy controls., The impact of antipsychotic medication type and its duration, sex, age, diagnosis, and duration of illness (DOI) on the acute effect of GT-002 on the EEG paradigms in schizophrenia spectrum patients.

Source: https://euclinicaltrials.eu/ctis-public/view/2024-519389-28-00